EU clinical trial 2024-511478-56-00: dTap booster vaccination of health care workers (HC dTap)
Sponsor: Varsinais-Suomen hyvinvointialue (Hospital/Clinic/Other health care facility). Phase: Therapeutic use (Phase IV). Countries: Finland (ended).
Therapeutic area(s): Diseases [C] - Bacterial Infections and Mycoses [C01]
Gender: Female, Male. Age: 18-64 years, 65+ years. Enrolment: 100.
Status: Ended. Start date (EU): 2024-05-03. End date (EU): 2026-02-28. Decision date: 2024-04-24. Results received: No. Last updated: 2024-04-24.

Condition(s): Diphtheria, tetanus, pertussis (wooping cough)
Product: Triaxis injektioneste, suspensio, esitäytetty ruisku. Kurkkumätä, jäykkäkouristus ja hinkuyskä (soluton, komponentti) -rokote (adsorboitu, vähennetty antigeeni(en) pitoisuus)

Primary endpoint: The percentage of study participants with PT-specific IgG antibody geometric mean concentration (GMC) ≥5 IU/mL 0-7 days pre-vaccination.
Endpoint(s): PT-specific IgG antibody geometric mean concentration (GMC) 28 days after vaccination., The difference in FHA, PRN, and Fimbriae 2/3 IgG antibody GMCs pre- and 28 days post-vaccination., Pertussis antigen-specific plasma B-cell frequencies pre- and 28 days post-vaccination measured by ELISpot., Pertussis antigen-specific memory B-cell frequencies pre- and 28 days post-vaccination measured by ELISpot., Pertussis antigen-specific T-cell responses determined by cytokine analysis either from pertussis antigen stimulated whole blood samples/PBMC’s and/or supernatants., Assays measuring pertussis specific functional immunity include: PT neutralization; PT epitope specific antibodies; avidity; adherence inhibition; bactericidal activity; bacterial opsonization and phagocytosis undertaken on serum samples taken pre- and 28 days post-vaccination., Tetanus- and diphtheria toxoid-specific IgG antibody GMC measured by ELISA pre- and 28 days post-vaccination.

Source: https://euclinicaltrials.eu/ctis-public/view/2024-511478-56-00